EU clinical trial 2026-525191-26-00: Efficacy of top-down therapy with mirikizumab versus standard of care with azathioprine in patients with newly diagnosed, moderate-to-severe Crohn’s disease: A 52-week, multicenter, open-label, randomized controlled trial
Protocol code: MIRAGE
Sponsor: Universitaetsklinikum Schleswig-Holstein AöR (Hospital/Clinic/Other health care facility). Phase: Therapeutic use (Phase IV). Countries: Germany (authorised, recruitment pending).
Therapeutic area(s): Diseases [C] - Digestive System Diseases [C06]
Gender: Female, Male. Age: 18-64 years, 65+ years. Enrolment: 320.
Status: Authorised, recruitment pending. Decision date: 2026-06-11. Results received: No. Last updated: 2026-07-02.

Condition(s): Crohn’s disease
Product: AZATHIOPRINE, MIRIKIZUMAB, MIRIKIZUMAB, MIRIKIZUMAB

Primary endpoint: Proportion of patients in deep remission at Week 52 (mITT), defined as patient level combination of all of the following: clinical remission: CDAI <150, endoscopic criterion: SES-CD ≤2 with no deep ulcers (central read), steroid-free: no systemic glucocorticoids within 8 weeks prior to Week 52, no IBD-related surgery through Week 52, no actively draining fistula at Week 52 and no new fistula through Week 52, no new clinically relevant stenosis through Week 52.

Source: https://euclinicaltrials.eu/ctis-public/view/2026-525191-26-00